EU clinical trial 2025-524178-40-00: A study to learn more about how safe nurandociguat is and how it affects the way the body processes rosuvastatin and dabigatran in healthy adults
Protocol code: 22600
Sponsor: Bayer AG (Pharmaceutical company). Phase: Human Pharmacology (Phase I)- Other. Countries: Germany (ended).
Therapeutic area(s): Diseases [C] - Cardiovascular Diseases [C14]
Gender: Female, Male. Age: 18-64 years. Enrolment: 40.
Status: Ended. End date (EU): 2026-05-22. Decision date: 2026-03-09. Results received: No. Last updated: 2026-03-24.

Condition(s): Chronic Kidney Disease

Source: https://euclinicaltrials.eu/ctis-public/view/2025-524178-40-00